EU clinical trial 2023-506991-28-00: In situ injection of anti-angiogenics in patients with brain arteriovenous malformations not eligible for exclusion treatment: phase I trial (BLITZ)
Protocol code: APHP 211033
Sponsor: Assistance Publique Hopitaux De Paris (Hospital/Clinic/Other health care facility). Phase: Human Pharmacology (Phase I)- Other. Countries: France (authorised, recruitment pending).
Therapeutic area(s): Diseases [C] - Cardiovascular Diseases [C14]; Diseases [C] - Congenital, Hereditary, and Neonatal Diseases and Abnormalities [C16]
Gender: Female, Male. Age: 18-64 years. Enrolment: 20.
Status: Authorised, recruitment pending. Decision date: 2025-01-27. Results received: No. Last updated: 2026-03-31.

Condition(s): Cardiology and vascular disease

Source: https://euclinicaltrials.eu/ctis-public/view/2023-506991-28-00